EU clinical trial 2025-524100-29-00: An Open-Label, Phase 1b, Multiple Ascending Dose Study of OM336 in Participants with Active Sjogren’s Disease or Idiopathic Inflammatory Myopathy
Protocol code: OM336-SAI-1002
Sponsor: Ouro Medicines Limited (Pharmaceutical company). Phase: Human Pharmacology (Phase I)- Other. Countries: Czechia (authorised, recruitment pending).
Therapeutic area(s): Diseases [C] - Immune System Diseases [C20]
Gender: Female, Male. Age: 18-64 years, 65+ years. Enrolment: 8.
Status: Authorised, recruitment pending. Decision date: 2026-04-21. Results received: No. Last updated: 2026-04-21.

Condition(s): Seropositive autoimmune disease: Sjogren’s disease or idiopathic inflammatory myopathy

Source: https://euclinicaltrials.eu/ctis-public/view/2025-524100-29-00